EU clinical trial 2023-504547-14-01: Calcium Channel blocker in treatment of reversible cerebral vasoconstriction syndrome: a double-blind, randomized, placebo-controlled trial.
Sponsor: HUS Helsinki University Hospital (Hospital/Clinic/Other health care facility). Phase: Therapeutic use (Phase IV). Countries: Finland (authorised, recruitment pending).
Therapeutic area(s): Diseases [C] - Nervous System Diseases [C10]
Gender: Female, Male. Age: 18-64 years, 65+ years. Enrolment: 100.
Status: Authorised, recruitment pending. Decision date: 2025-05-05. Results received: No. Last updated: 2026-04-13.

Condition(s): Reversible cerebral vasoconstriction syndrome
Product: AMLODIPINE

Primary endpoint: Frequency of recurring headache
Endpoint(s): Occurrence of any radiological complication (ischemic stroke, SAH, ICH, PRES) on computed tomography or magnetic resonance tomography, Radiological reversibility of the vasoconstriction on the follow-up CTA/MRA, Intensity of recurring headache attacks

Source: https://euclinicaltrials.eu/ctis-public/view/2023-504547-14-01